EU clinical trial 2023-504171-24-00: DUPI REDUCE trial (DUPIlumab dose REDUCtion in patients with controlled atopic Eczema): a multicenter, low-intervention, non-inferiority randomized controlled trial, embedded in the TREAT NL registry.
Protocol code: DUPI REDUCE trial
Sponsor: Amsterdam UMC (Hospital/Clinic/Other health care facility). Phase: Therapeutic use (Phase IV). Countries: Netherlands (ongoing, recruitment ended).
Therapeutic area(s): Diseases [C] - Skin and Connective Tissue Diseases [C17]
Gender: Female, Male. Age: 18-64 years. Enrolment: 216.
Status: Ongoing, recruitment ended. Start date (EU): 2023-08-14. Decision date: 2023-06-14. Results received: No. Last updated: 2024-12-02.

Condition(s): Atopic eczema
Product: Dupixent 300 mg solution for injection in pre-filled syringe

Primary endpoint: The mean Eczema Area and Severity Index (EASI) at week 16.
Endpoint(s): EASI at week 24., Validated Investigator Global Assessment for Atopic Dermatitis (vIGA-AD)., Patient self-reported Global Assessment of disease severity (PtGA)., Peak Pruritus Numerical Rating Scale (NRS)., Patient-Oriented Eczema Measure (POEM)., Dermatology Life Quality Index (DLQI)., Recap of atopic eczema (RECAP)., Dupilumab costs., EuroQol-5 dimensions-5 level/Youth (EQ-5D-5L): adults and caregivers., Adapted iMCQ (iMTA Medical Consumption Questionnaire)., Adapted iPCQ (iMTA Productivity Cost Questionnaire)., Adapted iVICQ (iMTA Valuation of Informal Care Questionnaire)., Number of adverse events of special interests (AEoSIs), severe adverse events, serious adverse events and suspected unexpected serious adverse reactions (SUSARs), categorized according to medical dictionary for regulatory activities (MedDRA)., Percentage of dropouts and reasons., Dupilumab serum trough levels of 40 patients.

Source: https://euclinicaltrials.eu/ctis-public/view/2023-504171-24-00